EU clinical trial 2024-515494-95-00: A Phase II, Multicenter, Double-Blind, Placebo-Controlled, Study to Assess the Efficacy and Safety of RO7790121 in Patients with Moderate to Severe Atopic Dermatitis
Protocol code: CS45570
Sponsor: F. Hoffmann-La Roche AG (Pharmaceutical company). Phase: Therapeutic exploratory (Phase II). Countries: Poland (ended), Italy (ongoing, recruitment ended), Spain (ongoing, recruitment ended), France (ended), Germany (ongoing, recruitment ended).
Therapeutic area(s): Phenomena and Processes [G] - Immune System Phenomena [G13]
Gender: Female, Male. Age: 18-64 years, 65+ years. Enrolment: 71.
Start date (EU): 2025-05-26. Decision date: 2025-04-22. Results received: No. Last updated: 2026-08-05.
Decision dates by country: IT: 2025-04-22, PL: 2025-04-27, FR: 2025-04-22, ES: 2025-04-24, DE: 2025-04-24

Condition(s): Moderate to Severe Atopic Dermatitis (AD)
Product: RO7790121, RO7790121 Placebo

Primary endpoint: 1. Proportion of participants who achieve eczema area and severity index-75 (EASI-75) response (≥ 75% improvement from baseline) Week 16
Endpoint(s): 1. Proportion of participants who achieve Investigator global assessment (IGA) score of clear (0) or almost clear (1) with ≥ 2-grade improvement at Week 16 and Week 32, 2. Proportion of participants who achieve EASI-75 response at Week 32, 3. Proportion of participants who achieve EASI-90 response at Week 16 and Week 32, 4. Percent change from baseline in EASI by visit, 5. Percent change from baseline in peak pruritus Numerical Rating Scale (NRS) score by visit, 6. Change from baseline in Dermatology Quality of Life Index at Week 16, Week 32 and by visit, 7. Proportion of EASI-75 responders at week 16, 8. Incidence and severity of the following: – Adverse events – Serious adverse events – Adverse events leading to study treatment discontinuation – Adverse events of special interest, 9. Change from baseline in selected vital signs, 10. Change from baseline in selected clinical laboratory test results, 11. Serum concentration of RO7790121 at specified timepoints

Source: https://euclinicaltrials.eu/ctis-public/view/2024-515494-95-00